EU clinical trial 2023-508881-14-00: A Phase 1b/2, Open-Label, Dose Finding, and Expansion Study of the Bcl‑2 Inhibitor BGB‑11417 in Patients With Myeloid Malignancies
Protocol code: BGB-11417-103
Sponsor: BeOne Medicines AG (Pharmaceutical company). Phase: Phase I and Phase II (Integrated)- Other. Countries: Spain (ongoing, recruiting), France (ongoing, recruiting), Germany (ongoing, recruiting), Italy (ongoing, recruiting).
Therapeutic area(s): Diseases [C] - Hemic and Lymphatic Diseases [C15]
Gender: Female, Male. Age: 18-64 years, 65+ years. Enrolment: 53.
Status: Ongoing, recruiting. Start date (EU): 2022-03-21. Decision date: 2024-02-29. Results received: No. Last updated: 2026-07-08.
Decision dates by country: DE: 2024-06-13, ES: 2024-02-29, IT: 2024-05-20, FR: 2024-03-05

Condition(s): Myeloid malignancies (acute myeloid leukemia (AML), myelodysplastic syndromes (MDS) and myelodysplastic syndrome/myeloproliferative neoplasms (MDS/MPN.
Product: POSACONAZOLE, BGB-11417, AZACITIDINE, BGB-11417, Azacitidine betapharm 25 mg/mL powder for suspension for injection, BGB-11417

Primary endpoint: Part 1 (dose regimen finding) and Part 2 (safety expansion) • Safety and tolerability of BGB-11417 in combination with azacitidine as assessed by dose-limiting toxicities (DLTs)and the incidence, timing, and severity of treatment-emergent adverse events (TEAEs), according to NCI-CTCAE v5.0., Part 3 (efficacy expansion) • For AML: - complete remission (CR) + complete remission with partial hematologic recovery (CRh) rate; - In the DDI cohort: PK endpoints of BGB-11417, including but not limited to area under the curve (AUC) and maximum plasma concentration (Cmax), derived from the plasma concentration-time profiles, • For MDS: modified overall response (mOR) rate, including CR, marrow complete remission (mCR), and partial remission (PR).
Endpoint(s): Part 1 (dose regimen finding) and Part 2 (safety expansion) For AML: • CR + morphologic complete remission with partial hematologic recovery (CRh) rate. For MDS: • Modified overall response (mOR) rate. mOR is defined as achieving a CR, marrow complete remission (mCR), or partial remission (PR) at any time point during the study per modified IWG 2006 criteria for MDS/MPN (Cheson et al 2006), Secondary pharmacokinetic (PK) endpoints for both AML and MDS: • Derived PK parameters, including: − For azacitidine: maximum observed plasma concentration (Cmax), area under plasma concentration-time curve (AUC0-t, AUC0-∞), half-life (t1/2), apparent total clearance of drug from plasma (CL/F), and apparent volume of distribution (Vz/F) as appropriate; − For BGB-11417: AUClast,ss, Cmax,ss, steady-state trough plasma concentration (Ctrough,ss) and tmax,ss., Part 3 (efficacy expansion) For AML: • CR rate; • CR + CR with incomplete hematologic recovery (CRi) rate; • ORR (CR + CRi + PR + morphologic leukemia-free state [MLFS]); • Duration of response of CR, CR + CRi, OR and CR + CRh; • Time to response (TTR) of CR, CR + CRi, OR and CR + CRh; • Event-free survival (EFS); • Overall survival (OS). • Transfusion independence (for at least consecutive 56-day postbaseline), Part 3 (efficacy expansion) For MDS: • CR rate; • Hematological improvement – erythroid (HI-E), as per IWG 2018 criteria; • Hematological improvement – platelet (HI-P), as per IWG 2018 criteria; • Hematological improvement – neutrophil (HI-N), as per IWG 2018 criteria; • Transfusion independence (for at least consecutive 56-day post-baseline); • EFS; • OS., Safety endpoints for both AML and MDS: • Safety and tolerability of BGB-11417 in combination with azacitidine or posaconazole as assessed by the incidence, timing, and severity of TEAEs, according to NCI-CTCAE v5.0.

Source: https://euclinicaltrials.eu/ctis-public/view/2023-508881-14-00